EU clinical trial 2024-516795-15-00: LAG3 PET; ImmunoPET imaging with 89Zr-DFO-REGN3767 in patients with advanced solid cancer prior to and during treatment with cemiplimab with or without platinum-based chemotherapy
Protocol code: 202000570
Sponsor: Universitair Medisch Centrum Groningen (Hospital/Clinic/Other health care facility). Phase: Therapeutic exploratory (Phase II). Countries: Netherlands (ongoing, recruiting).
Therapeutic area(s): Diseases [C] - Neoplasms [C04]
Gender: Female, Male. Age: 18-64 years, 65+ years. Enrolment: 38.
Status: Ongoing, recruiting. Start date (EU): 2024-11-27. Decision date: 2024-11-25. Results received: No. Last updated: 2024-11-25.

Condition(s): Metastatic solid tumors, these may include but are not limited to melanoma, non-small-cell lung carcinoma (NSCLC), cervical cancer, microsatellite instable (MSI)-high/deficient mismatch repair (dMMR) cancer, renal cell carcinoma (RCC), CSCC, urothelial cell carcer (UCC), small cell lung cancer (SCLC) and head and neck squamous cell carcinoma (HNSCC).
Product: Fianlimab, LIBTAYO 350 mg concentrate for solution for infusion.

Primary endpoint: Comparison of standardized uptake values in tumor lesions and tumor-to-blood ratios at different time points and different 89Zr-DFO-REGN3767 antibody dose levels., To evaluate the biodistribution and PK of 89Zr-DFO-REGN3767 antibody by measuring standardized uptake value (SUV) on 89Zr-DFO-REGN3767 PET scans in patients with histologically or cytologically documented locally advanced or metastatic solid tumors who based on available clinical data may benefit from treatment with cemiplimab with or without platinum-based chemotherapy., Safety evaluation through summaries of adverse events, changes in laboratory test results and changes in vital signs after exposure to 89Zr-DFO-REGN3767.
Endpoint(s): Comparison of tracer uptake, expressed as standardized uptake values, in different tumor lesions within and between patients on 89Zr-PET scans., Correlation of tumor tracer uptake with tumor and immune cell LAG3 expression as assessed by immunohistochemistry on a tumor biopsy sample., Correlation of tumor tracer uptake with response to cemiplimab with or without platinum-based chemotherapy, according to RECIST v1.1., Assessment of change in tumor and normal organ tracer uptake after 2 cycles of cemiplimab with or without chemotherapy

Source: https://euclinicaltrials.eu/ctis-public/view/2024-516795-15-00